EU clinical trial 2024-518035-11-01: Ebastine in combination with docetaxel or cabazitaxel as a treatment for metastatic castration-resistant prostate cancer
Sponsor: Rigshospitalet (Hospital/Clinic/Other health care facility). Phase: Therapeutic exploratory (Phase II). Countries: Denmark (ongoing, recruiting).
Therapeutic area(s): Diseases [C] - Male Urogenital Diseases [C12]
Gender: Male. Age: 18-64 years, 65+ years. Enrolment: 30.
Status: Ongoing, recruiting. Start date (EU): 2024-06-02. Decision date: 2024-12-09. Results received: No. Last updated: 2025-08-22.

Condition(s): metastatic castration-resistant prostate cancer (mCRPC)
Product: TAXOTERE 20 mg/1 ml concentrate for solution for infusion, Ebastin Orifarm 20 mg filmdragerade tabletter, JEVTANA 60 mg concentrate and solvent for solution for infusion.

Primary endpoint: Change in blood and urine Bis(monoacylglycero)phosphate (BMP)
Endpoint(s): • PSA response rate (≥ 50% decline in PSA compared to baseline according to PCWG3.) • Radiologic progression free survival (rPFS). • Time to PSA progression defined in accordance with PCWG3. • Toxicity in the combination of docetaxel and ebastine.

Source: https://euclinicaltrials.eu/ctis-public/view/2024-518035-11-01